EU clinical trial 2023-507504-31-00: A PHASE-1, FIRST-IN-HUMAN, RANDOMIZED, DOUBLE-BLIND, PLACEBO-CONTROLLED, SINGLE AND MULTIPLE ASCENDING DOSE STUDY TO ASSESS THE SAFETY, TOLERABILITY, PHARMACOKINETICS, PHARMACODYNAMICS, FOOD EFFECT, AND DRUG-DRUG INTERACTION OF ORALLY ADMINISTERED VENT-03 IN HEALTHY VOLUNTEERS
Protocol code: VENT-03-101
Sponsor: Ventus Therapeutics U.S. Inc. (Pharmaceutical company). Phase: Human Pharmacology (Phase I)- First administration to humans. Countries: Netherlands (ended).
Therapeutic area(s): Diseases [C] - Immune System Diseases [C20]
Gender: Female, Male. Age: 18-64 years. Enrolment: 84.
Status: Ended. Start date (EU): 2025-01-14. End date (EU): 2025-07-29. End date: 2025-07-30. Decision date: 2023-11-09. Results received: No. Last updated: 2025-05-06.

Condition(s): Lupus erythematosus

Source: https://euclinicaltrials.eu/ctis-public/view/2023-507504-31-00